EU clinical trial 2024-519722-20-00: Evaluation of the effect of Opioid-Free Anesthesia on oxygenation in bariatric surgery
Sponsor: Fundacion Publica Andaluza Para La Investigacion De Malaga En Biomedicina Y Salud (Laboratory/Research/Testing facility). Phase: Phase II and Phase III (Integrated). Countries: Spain (authorised, recruitment pending).
Therapeutic area(s): Analytical, Diagnostic and Therapeutic Techniques and Equipment [E] - Anesthesia and Analgesia [E03]
Gender: Female, Male. Age: 18-64 years. Enrolment: 72.
Status: Authorised, recruitment pending. Decision date: 2024-11-20. Results received: No. Last updated: 2024-11-20.

Condition(s): bariatric surgery
Product: KETOLAR 50 mg/ml solución inyectable.

Primary endpoint: To evaluate the effect of Opioid-Free Anesthesia on the Arterial Oxygen Pressure/Inspired Fraction of Oxygen (PaO2/FiO2) ratio during the first 6 postoperative hours in comparison with conventional anesthesia.

Source: https://euclinicaltrials.eu/ctis-public/view/2024-519722-20-00